EU clinical trial 2024-517670-15-00: Randomized Clinical Trial of Inhaled Sedation with Sevoflurane in Critically Ill Patients at Risk of Developing the Acute Respiratory Distress Syndrome
Protocol code: AOI 2019 JABAUDON
Sponsor: CHU Gabriel-Montpied (Hospital/Clinic/Other health care facility). Phase: Therapeutic confirmatory (Phase III). Countries: France (ended).
Therapeutic area(s): Analytical, Diagnostic and Therapeutic Techniques and Equipment [E] - Anesthesia and Analgesia [E03]
Gender: Female, Male. Age: 18-64 years, 65+ years. Enrolment: 80.
Status: Ended. Start date (EU): 2023-07-24. End date (EU): 2026-04-13. Decision date: 2024-10-10. Results received: No. Last updated: 2025-11-10.

Condition(s): Patients in ICU with risks of Acute Respiratory Distress Syndrome
Product: DIPRIVAN 20 mg/ml, émulsion injectable en seringue pré-remplie, HYPNOVEL 1 mg/ml, solution injectable, SEVOFLURANE BAXTER 1 ml/ml, liquide pour inhalation par vapeur, Dexmedetomidine 100 micrograms/ml concentrate for solution for infusion, NIMBEX 5 mg/ml, solution injectable/pour perfusion

Primary endpoint: longitudinal evolution in the PaO2/FiO2 ratio
Endpoint(s): Progression to ARDS will be assessed according to the Berlin criteria, including chest radiographs, Rate of pneumonia, Ventilator-free days, Organ failure-free days, Mortality, Length of ICU-stay, Physiological measures, ICU-acquired delirium, Biomarker measurements

Source: https://euclinicaltrials.eu/ctis-public/view/2024-517670-15-00